EU clinical trial 2024-518126-32-00: A phase I trial evaluating the safety, tolerability, and pharmacokinetic profile of INP12 in patients with advanced solid tumors.
Protocol code: INP12-01
Sponsor: Innoup Farma S.L. (Pharmaceutical company). Phase: Human Pharmacology (Phase I)- First administration to humans. Countries: Spain (ongoing, recruiting).
Therapeutic area(s): Diseases [C] - Neoplasms [C04]
Gender: Female, Male. Age: 18-64 years, 65+ years. Enrolment: 70.
Status: Ongoing, recruiting. Start date (EU): 2022-09-15. Decision date: 2024-09-25. Results received: No. Last updated: 2026-02-09.

Condition(s): Patients with advanced solid tumors.

Source: https://euclinicaltrials.eu/ctis-public/view/2024-518126-32-00